EU clinical trial 2022-501308-90-00: WINDOW-OF-OPPORTUNITY UMBRELLA PLATFORM TRIAL OF SHORT-COURSE PRE-OPERATIVE OR NEOADJUVANT TARGETED TREATMENT IN PATIENTS WITH MOLECULARLY SELECTED AND RESECTABLE PRIMARY COLORECTAL CANCER: THE UNICORN STUDY
Protocol code: UNICORN
Sponsor: Fondazione GONO G.I. (Patient organisation/association). Phase: Therapeutic exploratory (Phase II). Countries: Italy (ongoing, recruiting).
Therapeutic area(s): Diseases [C] - Neoplasms [C04]
Gender: Female, Male. Age: 18-64 years, 65+ years. Enrolment: 112.
Status: Ongoing, recruiting. Start date (EU): 2023-05-24. Decision date: 2023-04-26. Results received: No. Last updated: 2026-06-03.

Condition(s): Molecularly selected and resectable primary colorectal cancer
Product: BOTENSILIMAB, SOTORASIB, DS-8201a, DURVALUMAB, NIVOLUMAB, JNJ-61186372, CR6086, BALSTILIMAB, PANITUMUMAB

Primary endpoint: The major pathological response rate defined as the percentage of patients, relative to the total of enrolled subjects in the intention-to-treat population for each cohort, who will achieve a pCR or pMR response as per central pathological review.
Endpoint(s): Safety and tolerability will be assessed in terms of AEs (including SAEs), laboratory data, vital signs, ECGs, and exposure, that will be collected for all patients enrolled in the trial and receiving at least 1 dose of any study drugs., Quality of life will be defined by a series of Patient Reported Outcomes (PROs) assessed in each cohort by the completion of quality-of-life questionnaires, European Organization for Research and Treatment of Cancer (EORTC) QLQ-C30, EORTC QLQ-CR-29 and EuroQol EQ-5DL, during the pre-operative treatment phase., The transcriptional tumor/microenvironmental changes induced by the specific pre-operative targeted treatment will be resolved spatially by the evaluation of the gene expression profiles in different tumor compartments (cancer cells, lymphocytes, and macrophages) in matching pre- and post-treatment samples by comprehensive transcriptomic analyses on the GeoMx DSP platform and by multiplex IHC (CODEX)., The changes in systemic immunity induced by the specific pre-operative targeted treatment will be defined by the longitudinal analysis of the peripheral blood subpopulations including myeloid cells (including myeloid-derived suppressor cells), CD8+ and CD4+ T lymphocytes (including T regulatory and Th17 cells), their proliferation and activation/exhaustion state collected at different time points performed by multiparametric cytometry., The correlation of pCR/pMR with ctDNA mutational profiles and its clearance after the specific short-course preoperative targeted treatment will be assessed by using ultra-deep whole-exome sequencing with Unique Molecular Identifiers to evaluate with high accuracy the presence of ctDNA in longitudinally collected liquid biopsies., To investigate the prognostic and/or predictive impact of radiogenomic or radiomic signatures in specific molecular subgroups, the baseline imaging will be analyzed to predict specific molecular profiles in all pre-screened patients, while the matched pre- and post-treatment imaging will be analyzed to predict tumor heterogeneity and pathological response in each cohort., The prognostic and/or predictive value of microbiota in specific molecular subgroups will be defined by investigating the composition of the gut microbiome in stool samples collected at pre-screening and at the end of short-course pre-operative treatment, its impact on outcomes of populations of molecular interest and its influence on the local and systemic immune responses to specific short-course preoperative treatments in each cohort.

Source: https://euclinicaltrials.eu/ctis-public/view/2022-501308-90-00